EU clinical trial 2024-513622-35-00: [18F]mFBG PET-CT imaging of pheochromocytoma
Protocol code: 21-513
Sponsor: Universitair Medisch Centrum Utrecht (Hospital/Clinic/Other health care facility). Phase: Therapeutic exploratory (Phase II). Countries: Netherlands (ended).
Therapeutic area(s): Diseases [C] - Neoplasms [C04]
Gender: Female, Male. Age: 18-64 years, 65+ years. Enrolment: 10.
Status: Ended. Start date (EU): 2024-08-05. End date (EU): 2026-06-18. Decision date: 2024-08-05. Results received: No. Last updated: 2024-08-05.

Condition(s): Pheochromocytoma – endocrine adrenal tumor
Product: 1-(3-(fluoro-18F)benzyl)guanidine ([18F]mFBG)

Primary endpoint: The number of detected pheochromocytoma lesions, proved by histology, with pathological [18F]mFBG uptake, defined as focal uptake above surrounding normal tissue, compared to number of lesions detected on protocollary conventional CT imaging prior to surgery.
Endpoint(s): 1)Optimal time point of [18F]mFBG PET-CT imaging via comparison of SUV values at 1 and 2 hours on PET-CT imaging. 2) Correlation of [18F]mFBG PET findings with pathology and immunohistochemistry analysis of norepinephrine transporter. 3) Estimation of radiation dose of [18F]mFBG in normal tissues using dynamic PATLAK imaging 4) Safety analysis of [18F]mFBG administration on clinical symptoms will be evaluated by Adverse Events outcomes

Source: https://euclinicaltrials.eu/ctis-public/view/2024-513622-35-00